EU clinical trial 2023-508293-28-00: A Study to Evaluate the Efficacy, Safety, and Pharmacokinetics of IgPro20 (Subcutaneous Immunoglobulin, Hizentra®) in Adults with Dermatomyositis (DM) – The RECLAIIM Study
Sponsor: CSL Behring LLC (Pharmaceutical company). Phase: Therapeutic confirmatory (Phase III). Countries: Hungary (ended), France (ended), Italy (ended), Spain (ended), Germany (ended), Belgium (ended), Poland (ended).
Therapeutic area(s): Diseases [C] - Skin and Connective Tissue Diseases [C17]
Gender: Female, Male. Age: 18-64 years, 65+ years. Enrolment: 66.
Status: Ended. Start date (EU): 2020-02-20. End date (EU): 2024-10-21. End date: 2024-12-02. Decision date: 2024-04-11. Results received: Yes. Last updated: 2024-10-24.
Decision dates by country: BE: 2024-04-18, FR: 2024-04-12, HU: 2024-04-12, IT: 2024-05-03, ES: 2024-04-12, PL: 2024-04-16, DE: 2024-04-11

Condition(s): Dermatomyositis
Product: 2% human albumin, Hizentra 200 mg/ml solution for subcutaneous injection

Primary endpoint: Responder rate: A responder is defined as a subject with a total improvement score(TIS) ≥ 20 points at Week 25 and at least 1 of the previous scheduled visits (Week 17 or Week 21), who completes 24 weeks of randomized IMP treatment without the use of rescue corticosteroid treatment. The TIS is a sum response criterion which incorporates 6 weighted IMACS core set measures (CSMs).
Endpoint(s): Mean Total Improvement Score (TIS) - Up to Week 25, Point estimates and 95% CI for mean difference (IgPro20 – placebo) in TIS - Up to Week 25, Mean changes from Baseline in Manual Muscle Testing (MMT-8) - Up to Week 25, Point estimates and 95% CI for mean change difference (IgPro20 – placebo) in MMT-8 - Up to Week 25, Mean changes from Baseline in Cutaneous Dermatomyositis Disease Area and Severity Index (CDASI) total activity score - Up to Week 25, Point estimates and 95% CI for mean change difference (IgPro20 – placebo) - Up to Week 25, Number of subjects who are able to reduce the oral corticosteroid dose by ≥ 25% - Up to Week 25, Percentage and 95% CI of subjects who are able to reduce the oral corticosteroid dose by ≥ 25% - Up to Week 25, Point estimates and 95% CI for the odds ratio (IgPro20:Placebo) of subjects who are able to reduce the oral corticosteroid dose by ≥ 25% - Up to Week 25, Mean TIS - Week 5 up to Week 53, Percentage of subjects achieving TIS ≥ 20, ≥ 40, and ≥ 60 points - Week 5 up to Week 53, Time to first achieving TIS ≥ 20, ≥ 40, and ≥ 60 points on the TIS - Week 5 up to Week 53, Percentage of subjects achieving TIS ≥ 20 points at the end of study period 2 - Up to Week 53, Mean changes in individual CSMs (except muscle enzymes) and CDASI from Baseline - Between Week 5 and Week 25, Mean changes in individual CSMs (except muscle enzymes) and CDASI from Week 25 - Week 29 to Week 53, Number of subjects meeting Definition of Worsening (DOW) at least once, twice, or > twice - Baseline up to Week 53, Percentage of subjects meeting DOW at least once, twice, or > twice - Baseline up to Week 53, Time to meeting DOW for the first time - Baseline up to Week 53, Number of subjects meeting DOW and receiving rescue corticosteroid treatment - Baseline up to Week 53, Percentage of subjects meeting DOW and receiving rescue corticosteroid treatment - Baseline up to Week 53, Number of subjects who start oral corticosteroid dose taper - Baseline up to Week 53, Percentage of subjects who start oral corticosteroid dose taper - Baseline up to Week 53, Number of subjects who are able to reduce the oral corticosteroid dose by ≥ 25%, ≥ 50%, ≥ 75% - Baseline up to Week 25, Number of subjects who are able to reduce the oral corticosteroid dose by ≥ 25%, ≥ 50%, ≥ 75% - Baseline up to Week 53, Percentage of subjects who are able to reduce the oral corticosteroid dose by ≥ 25%, ≥ 50%, ≥ 75% - Baseline up to Week 25, Percentage of subjects who are able to reduce the oral corticosteroid dose by ≥ 25%, ≥ 50%, ≥ 75% - Baseline up to Week 53, Percentage of subjects receiving rescue corticosteroid treatment - Baseline up to Week 25, Percentage of subjects whose rescue corticosteroid treatment is tapered - Baseline up to Week 25, Time to first intake of rescue corticosteroid treatment - Baseline up to Week 25, Number of subjects having at least 1 level, 2 levels, and more than 2 levels of improvement from Baseline in mobility, self-care, and usual activities domains of EQ-5D-5L - Baseline up to Week 53, Percentage of subjects having at least 1 level, 2 levels, and more than 2 levels of improvement from Baseline in mobility, self-care, and usual activities domains of EQ-5D-5L - Baseline up to Week 53, Number of subjects having no reduction in levels, at least 1 level, 2 levels, and more than 2 levels of improvement in mobility, self-care, and usual activities domains of EQ-5D-5L - Week 25 up to Week 53, Percentage of subjects having no reduction in levels, at least 1 level, 2 levels, and more than 2 levels of improvement in mobility, self-care, and usual activities domains of EQ-5D-5L - Week 25 up to Week 53, Percentage of subjects with Treatment Emergent Adverse Events (TEAEs) - Up to 8 years, Percentage of subjects with related TEAEs - Up to 8 years, Percentage of subjects with serious TEAEs - Up to 8 years, Rate of TEAEs per days with infusion - Up to 8 years, Rate of TEAEs per days with infusion, by severity - Up to 8 years, Rate of related TEAEs per days with infusion - Up to 8 years, Rate of serious TEAEs per days with infusion - Up to 8 years

Source: https://euclinicaltrials.eu/ctis-public/view/2023-508293-28-00